EU clinical trial 2024-516315-24-00: A phase III, randomized, double-masked, placebocontrolled, parallel-group, multicenter study of the safety and efficacy of OT-101 (Atropine Sulfate 0.01%) in treating the progression of myopia in pediatric subjects
Protocol code: OT-101-001
Sponsor: Ocumension (Hong Kong) Ltd. (Pharmaceutical company). Phase: Therapeutic confirmatory (Phase III). Countries: Ireland (ongoing, recruitment ended), Slovakia (ongoing, recruitment ended), Hungary (ongoing, recruitment ended), Poland (ongoing, recruitment ended), Spain (ongoing, recruitment ended).
Therapeutic area(s): Diseases [C] - Eye Diseases [C11]
Gender: Female, Male. Age: 0-17 years. Enrolment: 210.
Status: Ongoing, recruitment ended. Start date (EU): 2022-05-27. Decision date: 2024-11-26. Results received: No. Last updated: 2026-05-22.
Decision dates by country: IE: 2024-11-26, HU: 2024-11-29, SK: 2024-11-26, PL: 2024-12-02, ES: 2024-11-26

Condition(s): myopia
Product: Atropine Sulfate 0.01% Ophthalmic Solution, The placebo for this trial will be composed of excipients used to manufacture the investigational drug but without the active drug substance.

Primary endpoint: Percentage of study eyes with a -0.75 D of progressive myopia at Month 36 defined as an increase in spherical equivalent of -0.75 D or greater (i.e., change from baseline ≥ -0.75) as assessed by cycloplegic autorefraction.
Endpoint(s): Change from baseline to Month 36 in study eye spherical equivalent (D) as assessed by cycloplegic autorefraction, Change from baseline to Month 36 in study eye axial length as measured by cycloplegic biometry (a device will be selected and the same device to be used throughout the duration of this study)

Source: https://euclinicaltrials.eu/ctis-public/view/2024-516315-24-00